EU clinical trial 2025-523065-16-00: Tailored antiplatelet secondary prevention in non-cardioembolic ischemic stroke: a phase IV gender-stratified randomized controlled trial (TAILOR trial)
Protocol code: TAILOR trial
Sponsor: Azienda Unita Sanitaria Locale Di Bologna (Hospital/Clinic/Other health care facility). Phase: Therapeutic use (Phase IV). Countries: Italy (authorised, recruitment pending).
Therapeutic area(s): Diseases [C] - Cardiovascular Diseases [C14]
Gender: Female, Male. Age: 18-64 years, 65+ years. Enrolment: 1506.
Status: Authorised, recruitment pending. Decision date: 2026-01-28. Results received: No. Last updated: 2026-04-17.

Condition(s): Non-cardioembolic ischemic stroke
Product: Acido Acetilsalicilico Aurobindo 100 mg compresse gastroresistenti, TICLOPIDINA MYLAN GENERICS 250 mg compresse rivestite, Clopidogrel Zentiva 75 mg film-coated tablets

Primary endpoint: 12-month cumulative incidence (time to first event) of the composite of ischemic stroke, myocardial infarction, or cardiovascular death.
Endpoint(s): Adherence to treatment, tested at the 3-month and 12-month follow-up visit via: • Rate of ‘good adherence’ (score ≥20) at the 5-item Medication Adherence Report Scale (MARS-5, total score 5–25). • Rate of responder status (ASPI/ADP based on appropriate drug) at the follow-up aggregation test., Good Functional status at 12 months, defined and adjudicated according to modified Rankin Scale 0-2., 12-month single-items of the composite primary outcome., 12-month incidence of single-items of the composite safety outcome., Gender differences in the primary and secondary outcomes, Prevalence in CYP2C192 and CYP2C1917 polymorphisms rate between responders and non-responders., 3-month cumulative incidence (time to first event) of the composite of ischemic stroke, myocardial infarction, or cardiovascular death., 12-month incidence of major and minor bleeding (composite safety outcome).

Source: https://euclinicaltrials.eu/ctis-public/view/2025-523065-16-00